EU clinical trial 2024-515037-15-00: PCL-2 - PRIMARY PLASMA CELL LEUKEMIA: A PROSPECTIVE PHASE II STUDY INCORPORATING DARATUMUMAB TO CHEMOTHERAPY AND STEM CELL TRANSPLANTATION (PCL-2 STUDY)
Protocol code: APHP190205
Sponsor: Assistance Publique Hopitaux De Paris (Hospital/Clinic/Other health care facility). Phase: Therapeutic exploratory (Phase II). Countries: France (ongoing, recruitment ended).
Therapeutic area(s): Diseases [C] - Hemic and Lymphatic Diseases [C15]
Gender: Female, Male. Age: 18-64 years, 65+ years. Enrolment: 29.
Status: Ongoing, recruitment ended. Start date (EU): 2022-03-02. Decision date: 2024-11-06. Results received: No. Last updated: 2026-06-15.

Condition(s): PRIMARY PLASMA CELL LEUKEMIA: A PROSPECTIVE PHASE II STUDY INCORPORATING DARATUMUMAB TO CHEMOTHERAPY AND STEM CELL TRANSPLANTATION
Product: BORTEZOMIB, DARZALEX 1800 mg solution for injection, Revlimid 10 mg hard capsules, DEXAMETHASONE, DEXAMETHASONE, DEXAMETHASONE, Revlimid 5 mg hard capsules, BORTEZOMIB

Primary endpoint: The primary endpoint is the VGPR or better rate at the completion of induction phase (according to the IMWG response criteria)
Endpoint(s): Progression-free Survival, Overall Survival, Time to progression and Duration of Response, overall hematological response rates, Assess safety by type, frequency, severity, relationship of adverse events to study treatment and changes in vital signs, physical exams. Incidence of Treatment Emergent Adverse Event (TEAE), Serious Adverse Event (SAE) and laboratory abnormalities using National Cancer Institute (NCI) common toxicity criteria (CCTAE V4)., Evaluate response according to chromosomal structural abnormalities such as del(17p), t(4;14), t(11;14), t(14;16), t(14;20), amp(1q) and del(1p), Minimal residual disease (MRD) assessed by NGS, Quality of life (EORTC QLQ-C30 domain scores)

Source: https://euclinicaltrials.eu/ctis-public/view/2024-515037-15-00